EU clinical trial 2022-502224-49-00: Human papillomavirus vaccine effectiveness study among men who have sex with men
Sponsor: Geneeskundige En Gezondheidsdienst Amsterdam (Hospital/Clinic/Other health care facility). Phase: Therapeutic use (Phase IV). Countries: Netherlands (ongoing, recruiting).
Therapeutic area(s): Diseases [C] - Virus Diseases [C02]
Gender: Male. Age: 18-64 years. Enrolment: 730.
Status: Ongoing, recruiting. Start date (EU): 2023-02-06. Decision date: 2023-01-27. Results received: No. Last updated: 2023-12-08.

Condition(s): HPV infection, Prevention of HPV infection among healthy participants.
Product: Cervarix suspension for injection in multidose container Human Papillomavirus vaccine [Types 16, 18] (Recombinant, adjuvanted, adsorbed)

Primary endpoint: We will conduct an observational study and compare anal HPV-16/18 prevalence between vaccinated and unvaccinated MSM attending the sexual health center (SHC). We will primarily measure HPV-16 and HPV-18 DNA positivity.
Endpoint(s): DNA HPV16/18 DNA positivity and HPV16/18 seropositivity, HPV16/18 seropositivity 24 months post HPV vaccination

Source: https://euclinicaltrials.eu/ctis-public/view/2022-502224-49-00